EU clinical trial 2024-512331-72-00: INCMGA 0012-303: A Phase 3 Global, Multicenter, Double-Blind Randomized Study of Carboplatin-Paclitaxel With INCMGA00012 or Placebo in Participants With Inoperable Locally Recurrent or Metastatic Squamous Cell Carcinoma of the Anal Canal Not Previously Treated With Systemic Chemotherapy (POD1UM-303/InterAACT 2)
Sponsor: Incyte Corp. (Pharmaceutical company). Phase: Therapeutic confirmatory (Phase III). Countries: Germany (ended), France (ended), Norway (ended), Denmark (ended), Sweden (ended), Spain (ended), Italy (ended), Belgium (ended).
Therapeutic area(s): Diseases [C] - Neoplasms [C04]
Gender: Female, Male. Age: 18-64 years, 65+ years. Enrolment: 201.
Status: Ended. Start date (EU): 2020-12-22. End date (EU): 2025-09-26. End date: 2025-09-26. Decision date: 2024-05-16. Results received: No. Last updated: 2025-07-16.
Decision dates by country: SE: 2024-05-17, NO: 2024-05-16, IT: 2024-06-18, BE: 2024-06-19, ES: 2024-05-17, DE: 2024-05-21, FR: 2024-05-22, DK: 2024-05-16

Condition(s): Squamous Carcinoma of the Anal Canal
Product: Retifanlimab (INCMGA00012), CARBOPLATINE ACCORD 10 mg/ml, solution pour perfusion, Bendatax 6 mg/ ml, Placebo liquid (not containing the active substance, otherwise identical to INCMGA0012)

Primary endpoint: PFS, defined as the time from the date of randomization until disease progression according to RECIST v1.1 by BICR or death due to any cause.
Endpoint(s): OS, defined as the time from the date of randomization until death due to any cause., ORR, defined as the percentage of participants having a CR or PR, according to RECIST v1.1 as determined by BICR., DOR, defined as the time from the first documented response (CR or PR) according to RECIST v1.1 until disease progression as determined by BICR or death due to any cause., DCR, defined as the number of participants maintaining either an ORR or stable disease according to RECIST v1.1 as determined by BICR., Number of participants experiencing AEs and number of participants discontinuing study drug due to AEs.

Source: https://euclinicaltrials.eu/ctis-public/view/2024-512331-72-00